EU clinical trial 2025-525123-27-00: SERENDIPITY: phase III multicentric randomized study assessing the reduction of chronic prostate inflammation with Permixon®
Protocol code: SERENDIPITY
Sponsor: Azienda Ospedaliero Universitaria Careggi, University Of Florence (Hospital/Clinic/Other health care facility, Educational Institution). Phase: Therapeutic confirmatory (Phase III). Countries: Italy (authorised, recruitment pending).
Therapeutic area(s): Diseases [C] - Male Urogenital Diseases [C12]
Gender: Male. Age: 18-64 years, 65+ years. Enrolment: 410.
Status: Authorised, recruitment pending. Decision date: 2026-06-23. Results received: No. Last updated: 2026-06-23.

Condition(s): Benign prostatic hypertrophy
Product: PERMIXON 160 mg, gélule, Placebo matching Macrogol 6000. Non-authorised product, manufactured specifically for this clinical trial by Pierre Fabre Medicament Production (MIA No. 2025 247 1 2) and packaged/labelled/batch released by Creapharm (MIA No. 2025 001 1 2 4 10). One hard capsule contains only 350 mg Macrogol 6000. No active substance. EU MP number: not applicable. Marketing Authorisation: not applicable.

Primary endpoint: Proportion of patients undergoing a repeat prostate biopsy within 12 months
Endpoint(s): ln[PSA] value measured at 12 months, PINS score at 12 months, PIRADS score at 12 months, Number of lesions at 12 months, IS and IRANI score at 12 months, IPSS and IIEF-5 at 12 months, Proportion of patients diagnosed with prostate cancer within 12 months

Source: https://euclinicaltrials.eu/ctis-public/view/2025-525123-27-00